EU clinical trial 2024-511053-22-00: PiSCATIN - Simvastatin for the treatment of primary sclerosing cholangitis (PSC) - a randomized double-blind, placebo-controlled multicenter study
Sponsor: Karolinska University Hospital (Hospital/Clinic/Other health care facility). Phase: Therapeutic exploratory (Phase II). Countries: Sweden (ongoing, recruiting).
Therapeutic area(s): Diseases [C] - Neoplasms [C04]
Gender: Female, Male. Age: 18-64 years, 65+ years. Enrolment: 560.
Status: Ongoing, recruiting. Start date (EU): 2020-05-04. Decision date: 2024-02-26. Results received: No. Last updated: 2026-01-09.

Condition(s): Primary sclerosing cholangitis (PSC)
Product: Simvastatin Sandoz 40 mg filmdragerade tabletter, Placebo for Simvastatin Sandoz 40 mg tablets.

Primary endpoint: Number of days from randomisation to death, Number of days from randomisation to listing of liver transplantation, Number of days from randomisation to first variceal bleeding, Number of days from randomization to diagnosis bile duct cancer, gall bladder cancer or hepatocellular cancer (diagnosed with characteristic x-ray (focal) or histological/cytological diagnosis).
Endpoint(s): Serumconcentrations of alkaline phosphatase, Serumconcentration of bilirubin, MELD Score, Child Pugh Score, Progress of cholangiographic image with MR, Elastography, Symptoms related to PSC (itching or bacterial colangitis requiring treatment, ascites, encephalopathy), Dysplasia in the biliary tract or gall bladder, Development of colon cancer or dysplasia

Source: https://euclinicaltrials.eu/ctis-public/view/2024-511053-22-00